EU clinical trial 2023-506553-37-00: Examining the impact of propranolol on preoperative anxiety and on tumorigenic changes in patients with pancreatic ductal adenocarcinomas: a randomized, triple-blinded, placebo-controlled pilot trial (The IMPULS trial)
Sponsor: Zealand University Hospital (Hospital/Clinic/Other health care facility). Phase: Therapeutic exploratory (Phase II). Countries: Denmark (ongoing, recruiting).
Therapeutic area(s): Diseases [C] - Neoplasms [C04]; Diseases [C] - Digestive System Diseases [C06]
Gender: Female, Male. Age: 18-64 years, 65+ years. Enrolment: 30.
Status: Ongoing, recruiting. Start date (EU): 2024-04-23. Decision date: 2023-11-07. Results received: No. Last updated: 2026-01-27.

Condition(s): Pancreatic ductal adenocarcinoma (PDAC)
Product: PLACEBO, PROPRANOLOL, PROPRANOLOL

Primary endpoint: Anxiety levels measured by The Hamilton Anxiety Rating Scale (HAM-A) and by The Hospital Anxiety and Depression Scale (HADS). The European Organization for Research and Treatment of Cancer (EORTC) quality of life questionnaire (QoL) for pancreatic cancer will be used to assess quality of life. HRV data calculated from continuous ECG gathered by a Holter monitor. Follow up data: postoperative complications, survival 30-, 90- days and 1, 3-, 5- years after surgery. Blood and tissue sampling
Endpoint(s): Safety: Changes in resting HR and BP during the intervention. Symptoms and side effects to medicine: light-headedness, lethargy, hypotension, bradycardia and other symptoms/side-effects. Tertiary end points: feasibility and implementation using the APEASE framework

Source: https://euclinicaltrials.eu/ctis-public/view/2023-506553-37-00